EU clinical trial 2023-507689-26-00: A Phase III, Randomized, Double-Blind, Placebo-Controlled, Multi-Center Study of Durvalumab Monotherapy or in Combination With Bevacizumab as Adjuvant Therapy in Patients with Hepatocellular Carcinoma Who Are at High Risk of Recurrence After Curative Hepatic Resection or Ablation (EMERALD-2)
Protocol code: D910DC00001
Sponsor: Astrazeneca AB (Pharmaceutical company). Phase: Therapeutic confirmatory (Phase III). Countries: Poland (ongoing, recruiting), Austria (ongoing, recruiting), Italy (ongoing, recruiting), France (ongoing, recruiting), Germany (ongoing, recruiting).
Therapeutic area(s): Diseases [C] - Neoplasms [C04]
Gender: Female, Male. Age: 18-64 years, 65+ years. Enrolment: 94.
Status: Ongoing, recruiting. Start date (EU): 2019-10-07. Decision date: 2024-03-19. Results received: No. Last updated: 2025-10-14.
Decision dates by country: IT: 2024-03-25, PL: 2024-03-25, AT: 2024-03-19, DE: 2024-03-20, FR: 2024-03-19

Condition(s): Histologically or cytologically confirmed Locoregional Hepatocellular Carcinoma (HCC) and successfully completed curative therapy (resection or ablation)
Product: INFLIXIMAB, IMFINZI 50 mg/mL concentrate for solution for infusion., BEVACIZUMAB, MYCOPHENOLATE MOFETIL, DEXTROSE BP, SODIUM CHLORIDE

Primary endpoint: Recurrence-free survival (RFS)
Endpoint(s): Overall survival (OS) Time to recurrence (TTR) RFS at 24 months (RFS24) and RFS at 36 months (RFS36) Time from randomization to recurrence/progression on next therapy (RFS2/PFS2)

Source: https://euclinicaltrials.eu/ctis-public/view/2023-507689-26-00